EU clinical trial 2022-502570-16-01: A Phase 2, Double-Blind, Randomized, Placebo-Controlled, Dose-Ranging, Efficacy and Safety Study of Povorcitinib in Participants With Inadequately Controlled Moderate to Severe Asthma
Protocol code: INCB 54707-208
Sponsor: Incyte Corp. (Pharmaceutical company). Phase: Therapeutic exploratory (Phase II). Countries: Germany (ongoing, recruitment ended), Spain (ongoing, recruitment ended), Poland (ongoing, recruitment ended).
Therapeutic area(s): Diseases [C] - Respiratory Tract Diseases [C08]
Gender: Female, Male. Age: 18-64 years, 65+ years. Enrolment: 84.
Status: Ongoing, recruitment ended. Start date (EU): 2024-06-27. Decision date: 2024-05-27. Results received: No. Last updated: 2025-09-19.
Decision dates by country: PL: 2024-05-31, ES: 2024-05-27, DE: 2024-05-28

Condition(s): Treatment of patients with inadequately controlled moderate to severe asthma
Product: Povorcitinib, Placebo, Povorcitinib, Povorcitinib

Primary endpoint: Absolute change from baseline in pre-BD FEV1 at Week 24
Endpoint(s): Number of asthma exacerbations during the PC period, defined as a worsening of asthma that leads to any of the following: − Use of systemic CS for at least 3 consecutive days; a single depo-injectable dose of CS will be considered equivalent to a 3-day course of systemic CS, An emergency department or urgent care visit (defined as evaluation and treatment for < 24 hours in an emergency department or urgent care center) due to asthma that required use of systemic CS (as noted above), An inpatient hospitalization (defined as admission to an inpatient facility and/or evaluation and treatment in a healthcare facility for ≥ 24 hours) due to asthma

Source: https://euclinicaltrials.eu/ctis-public/view/2022-502570-16-01